EU clinical trial 2024-516854-23-00: Single-Ascending Doses of 2-Methoxyestradiol in Healthy Non-Pregnant Female Subjects.
Protocol code: BLCL-2ME-01
Sponsor: Laboratorios Leon Farma S.A. (Pharmaceutical company). Phase: Human Pharmacology (Phase I)- First administration to humans. Countries: Portugal (ended).
Therapeutic area(s): Not possible to specify
Gender: Female. Age: 18-64 years. Enrolment: 40.
Status: Ended. Start date (EU): 2024-11-11. End date (EU): 2025-06-25. Decision date: 2024-10-08. Results received: No. Last updated: 2026-03-26.

Condition(s): No medical condition.

Source: https://euclinicaltrials.eu/ctis-public/view/2024-516854-23-00